EU clinical trial 2023-505180-36-00: A Phase 1, Open-label, Pharmacokinetic Study of TVB-2640 in Subjects with Mild, Moderate, or Severe Hepatic Impairment Compared to Subjects with Normal Hepatic Function.
Protocol code: SB2640-CLIN-009
Sponsor: Sagimet Biosciences Inc. (Pharmaceutical company). Phase: Human Pharmacology (Phase I)- Other. Countries: Hungary (ended).
Therapeutic area(s): Not possible to specify
Gender: Female, Male. Age: 18-64 years, 65+ years. Enrolment: 16.
Status: Ended. Start date (EU): 2023-09-21. End date (EU): 2023-12-18. End date: 2023-12-19. Decision date: 2023-08-24. Results received: No. Last updated: 2023-08-24.

Condition(s): Impaired Hepatic Function; The study will enroll as following: · Group 1 (N up to 24) – Normal hepatic function (healthy subjects) · Group 2 (N 6 to 8) – Mild hepatic impairment (Child-Pugh A - a score of 5 to 6) · Group 3 (N 6 to 8) – Moderate hepatic impairment (Child-Pugh B a score of 7 to 9) · Group 4 (N 6 to 8) – Severe hepatic impairment (Child-Pugh C a score of 10 to 15) Healthy volunteers with normal hepatic function.

Source: https://euclinicaltrials.eu/ctis-public/view/2023-505180-36-00